EU clinical trial 2025-522878-36-00: A Phase 3b Long-term Efficacy and Safety Extension Study of Barzolvolimab in Participants with Chronic Spontaneous Urticaria Who Have Completed CDX0159-12 or CDX0159-13 (EMBARQ-CSU LTE)
Protocol code: CDX0159-17
Sponsor: Celldex Therapeutics Inc. (Pharmaceutical company). Phase: Therapeutic confirmatory (Phase III). Countries: Croatia (authorised, recruitment pending), France (ongoing, recruiting), Netherlands (authorised, recruitment pending), Bulgaria (ongoing, recruiting), Portugal (authorised, recruiting), Slovakia (authorised, recruitment pending), Hungary (authorised, recruitment pending), Italy (ongoing, recruiting), Greece (ongoing, recruiting), Germany (ongoing, recruiting), Czechia (authorised, recruitment pending), Lithuania (authorised, recruitment pending), Spain (ongoing, recruiting), Belgium (ongoing, recruiting), Denmark (authorised, recruiting), Poland (ongoing, recruiting).
Therapeutic area(s): Diseases [C] - Skin and Connective Tissue Diseases [C17]
Gender: Female, Male. Age: 18-64 years, 65+ years. Enrolment: 438.
Start date (EU): 2026-04-20. Decision date: 2026-03-16. Results received: No. Last updated: 2026-08-03.
Decision dates by country: SK: 2026-03-16, DK: 2026-03-16, HU: 2026-03-18, NL: 2026-03-17, BE: 2026-03-17, BG: 2026-03-17, LT: 2026-03-18, HR: 2026-03-20, GR: 2026-03-19, CZ: 2026-03-17, PT: 2026-03-17, ES: 2026-03-19, DE: 2026-03-18, PL: 2026-03-23, FR: 2026-03-16, IT: 2026-03-18

Condition(s): Chronic Spontaneous Urticaria
Product: BARZOLVOLIMAB, FASTJEKT 300 Mikrogramm, Injektionslösung im Fertigpen

Primary endpoint: Time to disease worsening or treatment failure through Week 52 based on the first of the following events: 1. Urticaria Activity Score over 7 days (UAS7) ≥ 16*, 2. Discontinuation of barzolvolimab in Group 2 (Barzolvolimab Retreatment Group) due to lack of efficacy or to a treatment related adverse event (AE), 3. First use of strongly confounding prohibited medication (Group 1 or 2) or use of barzolvolimab in Group 1
Endpoint(s): 1. In participants in Group 1 (Observation Group): Change from baseline (CDX0159-12 or CDX0159-13) in UAS7 at Week 26; at EOS, 2. In participants in Group 1 (Observation Group) with at least well-controlled disease (UAS7 ≤ 6) at baseline of Long-term Extension (LTE): Percentage of participants with at least well-controlled disease at Week 26; at EOS, 3. In participants in Group 1 (Observation Group) with complete control (UAS7 = 0) at baseline of LTE: Percentage of participants with at least well-controlled disease at Week 26; at EOS, 4. In participants in Group 1 (Observation Group) with chronic spontaneous urticaria (CSU) completely controlled (UAS7 = 0 and Angioedema Activity Score over 7 days [AAS7] = 0) at baseline of LTE: Percentage of participants with CSU completely controlled at Week 26; at EOS, 5. In participants in Group 1 (Observation Group) with at least well-controlled disease (UAS7 ≤ 6) at baseline of LTE: Time to loss of well-controlled disease through EOS, 6. In participants in Group 1 (Observation Group) with complete control of disease (UAS7 = 0) at baseline of LTE: Time to loss of complete control through EOS, 7. In participants in Group 1 (Observation Group) with CSU completely controlled (UAS7 = 0 and AAS7 = 0) at baseline of LTE: Time to loss of CSU completely controlled through EOS, 8i. In participants in Group 2 (Barzolvolimab Retreatment Group): • Change from LTE baseline UAS7 at Week 12; at Week 24; at Week 52; at EOS, 8ii. Percentage of participants with UAS7 ≤ 6 at Week 12; at Week 24; at Week 52; at EOS, 9i. In participants in Group 1 (Observation Group): Percentage of participants experiencing AEs from baseline through EOS, 9ii. In participants in Group 1 (Observation Group): Percentage of participants experiencing serious AEs from baseline through EOS, 9iii. In participants in Group 1 (Observation Group) who never receive barzolvolimab retreatment during the LTE: Percentage of participants experiencing non-treatment emergent AEs from baseline through EOS, 10i. In participants in Group 1 (Observation Group) who never receive barzolvolimab retreatment during the LTE: Percentage of participants experiencing non-treatment emergent serious AEs from baseline through EOS, 10ii. In participants in Group 1 (Observation Group) who receive barzolvolimab retreatment during the LTE: Percentage of participants experiencing treatment emergent adverse events (TEAEs) from baseline through EOS, 11i. In participants in Group 1 (Observation Group) who receive barzolvolimab retreatment during the LTE: Percentage of participants experiencing treatment emergent serious AEs from baseline through EOS, 11ii. In participants in Group 1 (Observation Group) who receive barzolvolimab retreatment during the LTE: Percentage of participants experiencing TEAEs leading to treatment discontinuation from baseline through EOS, 12. In participants in Group 2 (Barzolvolimab Retreatment Group): • Percentage of participants experiencing TEAEs from baseline through EOS • Percentage of participants experiencing treatment-emergent serious AEs from baseline through EOS • Percentage of participants experiencing TEAEs leading to treatment discontinuation from baseline through EOS

Source: https://euclinicaltrials.eu/ctis-public/view/2025-522878-36-00